EU clinical trial 2024-513214-34-00: A multi-center, single-arm, open-label study to evaluate tolerability, safety, and efficacy of topical MOB015B solution in the treatment of mild to moderate distal subungual onychomycosis (DSO) in subjects aged 6-17 years
Sponsor: Moberg Pharma AB (publ) (Pharmaceutical company). Phase: Therapeutic exploratory (Phase II). Countries: Iceland (authorised, recruitment pending), Poland (ongoing, recruiting), Denmark (ongoing, recruiting), Italy (ongoing, recruiting).
Therapeutic area(s): Diseases [C] - Bacterial Infections and Mycoses [C01]
Gender: Female, Male. Age: 0-17 years. Enrolment: 32.
Start date (EU): 2023-10-18. Decision date: 2024-07-25. Results received: No. Last updated: 2026-02-05.
Decision dates by country: IS: 2024-09-09, IT: 2024-08-05, PL: 2024-08-04, DK: 2024-07-25

Condition(s): Distal Subungual Onychomycosis
Product: Terbinafin "Moberg Pharma", kutanopløsning, Terbinafina Moberg Pharma 98 mg/mL soluzione cutanea, Terbinafina Moberg Pharma 98 mg/mL soluzione cutanea, Terclara, kutanopløsning, Terbinafina Moberg Pharma 98 mg/mL soluzione cutanea

Primary endpoint: Treatment success (defined as 0-10% clinical disease involvement of the target toenail and mycological cure of target toenail) at Week 48.

Source: https://euclinicaltrials.eu/ctis-public/view/2024-513214-34-00